EU clinical trial 2023-508335-31-00: ElucidatiNg Immunosuppressant pharmacokinetic variabilities by investigating Gut Microbiota modulations After kidney transplantation - ENIGMA
Protocol code: ENIGMA
Sponsor: Universite Catholique de Louvain (Educational Institution). Phase: Therapeutic use (Phase IV). Countries: Belgium (ongoing, recruiting).
Therapeutic area(s): Diseases [C] - Pathological Conditions, Signs and Symptoms [C23]
Gender: Female, Male. Age: 18-64 years. Enrolment: 50.
Status: Ongoing, recruiting. Start date (EU): 2024-09-02. Decision date: 2024-03-18. Results received: No. Last updated: 2025-10-27.

Condition(s): Chronic renal failure
Product: TACROLIMUS MONOHYDRATE, MYCOPHENOLATE MOFETIL, TACROLIMUS MONOHYDRATE, TACROLIMUS MONOHYDRATE

Primary endpoint: Immunosuppressive drug pharmacokinetic parameters, including tacrolimus, mycophenolic acid (the active moiety of mycophenolate mofetil) and glucuronides (MPA-glucuronide and acyl-MPA-glucuronide). Microbiota composition and function. Antibiotic pharmacokinetics

Source: https://euclinicaltrials.eu/ctis-public/view/2023-508335-31-00